EU clinical trial 2025-520846-31-00: Cannabidiol (Epidyolex) for behavioural problems in patients with Tuberous Sclerosis Complex, Sanfilippo and Fragile X syndrome: an N-of-1 series
Sponsor: Amsterdam UMC Stichting (Patient organisation/association). Phase: Therapeutic confirmatory (Phase III). Countries: Netherlands (authorised, recruitment pending).
Therapeutic area(s): Diseases [C] - Congenital, Hereditary, and Neonatal Diseases and Abnormalities [C16]
Gender: Female, Male. Age: 0-17 years, 18-64 years. Enrolment: 30.
Status: Authorised, recruitment pending. Decision date: 2025-10-30. Results received: No. Last updated: 2025-10-30.

Condition(s): Tuberous Sclerosis Complex (TSC), Sanfilippo syndrome, Fragile X syndrome (FXS)
Product: Oral Solution with beta-carotene, Epidyolex 100 mg/ml oral solution

Primary endpoint: The effectiveness of CBD on behavioural problems using the irritability subscale of the Aberrant Behavior Checklist (ABC) in children and adults with FXS, TSC and Sanfilippo syndrome
Endpoint(s): Effectiveness of CBD on symptom severity, measured bij change in Clinical Global Impression (CGI), Effectiveness of CBD on quality of life, measured by changes in syndrome specific outcome measures., Effectiveness of CBD on anxiety, depression and mood, measured by change in Anxiety, Depression and Mood Scale (ADAMS)., Effectiveness of CBD on autism symptoms, measured by change in Social Communication Questionnaire / Social Responsiveness Scale (SCQ/SRS-2) score, Effectiveness of CBD on sensory processing, measured by change in Short Sensory Profile (SP-NL), Effectiveness of CBD on parental stress, measured by change in Opvoedingsbelasting Vragenlijst (OBVL), Effectiveness of CBD on personal goals, measured by change in Goal Attainment Scaling (GAS), Effectiveness of CBD on focal and generalized seizure frequency, measured by keeping a seizure diary each time a seizure occurs., Safety and tolerability of CBD, measured by keeping track of adverse events and side effects, Monitoring of hepatic enzyme levels (ALT, AST, bilirubin)

Source: https://euclinicaltrials.eu/ctis-public/view/2025-520846-31-00